EU clinical trial 2024-518069-89-00: Precision medicine phase II study evaluating the efficacy of a double immunotherapy by Durvalumab and Tremelimumab combined with Olaparib in patients with solid cancers and carriers of homologous recombination repair genes mutation in response or stable after Olaparib treatment
Sponsor: Centr Georges Francois Leclerc (Hospital/Clinic/Other health care facility). Phase: Therapeutic exploratory (Phase II). Countries: France (ongoing, recruitment ended).
Therapeutic area(s): Diseases [C] - Neoplasms [C04]
Gender: Female, Male. Age: 18-64 years, 65+ years. Enrolment: 230.
Status: Ongoing, recruitment ended. Start date (EU): 2020-02-03. Decision date: 2024-10-15. Results received: No. Last updated: 2026-07-16.

Condition(s): Patients with solid cancers

Source: https://euclinicaltrials.eu/ctis-public/view/2024-518069-89-00